EU clinical trial 2024-520380-13-00: A Study to Learn How Different Amounts of the Study Medicine Called PF-07999415 are Tolerated and Act in the Body in Healthy Adults
Protocol code: C5671001
Sponsor: Pfizer Inc. (Pharmaceutical company). Phase: Human Pharmacology (Phase I)- First administration to humans. Countries: Belgium (ongoing, recruitment ended).
Therapeutic area(s): Diseases [C] - Nutritional and Metabolic Diseases [C18]
Gender: Female, Male. Age: 18-64 years, 65+ years. Enrolment: 53.
Status: Ongoing, recruitment ended. Start date (EU): 2025-06-17. Decision date: 2025-06-13. Results received: No. Last updated: 2026-01-23.

Condition(s): CCI

Source: https://euclinicaltrials.eu/ctis-public/view/2024-520380-13-00